EU clinical trial 2023-505868-11-00: EFFICACY OF COLCHICINE IN SECONDARY PREVENTION OF VASCULAR EVENTS AND RENAL PROGRESSION IN PATIENTS WITH MODERATE CHRONIC RENAL DISEASE (COLCHIREN STUDY).
Protocol code: FIBHGM-ECNC002-2022
Sponsor: Fundacion Para La Investigacion Biomedica Del Hospital Gregorio Maranon (Hospital/Clinic/Other health care facility). Phase: Therapeutic confirmatory (Phase III). Countries: Spain (ongoing, recruiting).
Therapeutic area(s): Not possible to specify
Gender: Female, Male. Age: 18-64 years, 65+ years. Enrolment: 744.
Status: Ongoing, recruiting. Start date (EU): 2025-01-17. Decision date: 2024-04-17. Results received: No. Last updated: 2025-11-12.

Condition(s): CHRONIC RENAL DISEASE
Product: clochicine, COLCHICINE

Primary endpoint: incidence of the primary event consisting of: death from cardiovascular causes; acute coronary syndrome; angina requiring hospitalisation; coronary revascularisation; transient ischaemic attack or non-cardioembolic ischaemic stroke; or peripheral vascular disease, defined as acute peripheral arterial embolism or ischaemia, or the need for amputation or percutaneous surgical revascularisation, Incidence of primary event consisting of death from cardiovascular causes; acute coronary syndrome; angina requiring hospitalization; coronary revascularization; transient ischemic attack or noncardioembolic ischemic stroke; or peripheral vasculopathy, defined as embolism or acute peripheral arterial ischemia, or need for amputation or surgical or percutaneous revascularization.
Endpoint(s): - Incidence of death from cardiovascular causes. - Incidence of acute coronary syndrome. - Incidence of hospitalization for cardiac angina. - Incidence of coronary revascularization. - Incidence of transient ischemic attack or noncardioembolic ischemic stroke. - Incidence of peripheral vasculopathy, defined as embolism or acute peripheral arterial ischemia, or need for amputation or percutaneous surgical revascularization., - Individual and combined incidence of renal events: o 40% decrease in glomerular filtration rate estimated by CKD-EPI with respect to baseline. o Doubling of serum creatinine over its baseline level. o Persistent drop in glomerular filtration rate estimated by CKD-EPI below 15 mL/min/1.73m2. o Need for renal replacement therapy on a sustained basis. - Effect on plasma levels of markers of inflammation, fibrosis and renal progression. - Incidence of adverse events.

Source: https://euclinicaltrials.eu/ctis-public/view/2023-505868-11-00